EU clinical trial 2023-510424-68-00: Phase I/II, Open-Label, Multicenter Study to Evaluate the Safety, Tolerability, and Preliminary Efficacy of Durvalumab Monotherapy or Durvalumab in Combination with Tremelimumab in Pediatric Patients with Advanced Solid Tumors and Hematological Malignancies
Protocol code: D419EC00001
Sponsor: AstraZeneca AB (Pharmaceutical company). Phase: Phase I and Phase II (Integrated)- Other. Countries: Spain (ongoing, recruiting).
Therapeutic area(s): Diseases [C] - Neoplasms [C04]
Gender: Female, Male. Age: 0-17 years. Enrolment: 11.
Status: Ongoing, recruiting. Start date (EU): 2019-05-28. Decision date: 2024-06-28. Results received: No. Last updated: 2026-01-14.

Condition(s): Advanced Solid Tumors
Product: IMFINZI 50 mg/mL concentrate for solution for infusion., IMJUDO 20 mg/ml concentrate for solution for infusion.

Primary endpoint: Based on PK parameters (including Cmax, Cmin, AUC, and others), identify the adult equivalent exposure/MTD of durvalumab in combination with tremelimumab and durvalumab as monotherapy following combination therapy, among children and young adults from birth to <18 years of age with advanced solid tumors using a q4w dosing schedule., Identify the safety and tolerability of durvalumab in combination with tremelimumab and durvalumab as monotherapy following combination therapy, at the adult equivalent exposure/MTD among children and young adults from birth to <18 years of age with advanced solid tumor using a q4w dosing schedule. Endpoints include AEs, vital signs, physical examinations, ECGs, and laboratory evaluations, Objective response rate as determined by the Investigator assessed RECIST 1.1 or alternative pre-specified tumor-specific response rates for different scoring systems. -Assessment of antitumor activity will be specific to tumor cohort, eg, Investigator assessed RECIST 1.1 (other malignancies will be analyzed based on the best response assessed by the Investigator)., Additional efficacy endpoints that will be collected include DoR, BoR, DCR, PFS, APF12, and APF18 based on RECIST 1.1 assessed by the Investigator, and OS, OS12, and OS24 as appropriate
Endpoint(s): Individual durvalumab and tremelimumab concentrations in serum, and PK parameters including Cmax, Cmin, AUC., Number and percentage of patients who develop detectable ADAs., Individual antibody titer measurements before and after planned routine immunization during treatment and Cycle 4 or follow-up, whichever is earlier., Flow cytometry for CD4, CD8, B and NK cells, including T-cell activation with Ki67

Source: https://euclinicaltrials.eu/ctis-public/view/2023-510424-68-00